EU clinical trial 2024-512484-31-00: Bemarituzumab in patients with FGFR2b-positive advanced or metastatic adenocarcinoma of the stomach or gastroesophageal junction, who failed at least one prior line of palliative chemotherapy - The IKF-AIO Phase IIa BEMARA trial
Sponsor: Frankfurter Institut Fuer Klinische Krebsforschung IKF GmbH (Pharmaceutical company). Phase: Therapeutic exploratory (Phase II). Countries: Germany (temporarily halted), Spain (authorised, recruitment pending).
Therapeutic area(s): Diseases [C] - Neoplasms [C04]
Gender: Female, Male. Age: 18-64 years, 65+ years. Enrolment: 146.
Start date (EU): 2025-02-28. Decision date: 2024-11-01. Results received: No. Last updated: 2026-07-27.
Decision dates by country: ES: 2025-10-09, DE: 2024-11-01

Condition(s): FGFR2b-positive, advanced or metastatic adenocarcinoma of the stomach or gastroesophageal junction
Product: PACLITAXEL, RAMUCIRUMAB, IRINOTECAN, Bemarituzumab, Lonsurf 15 mg/6.14 mg film-coated tablets

Primary endpoint: Objective response rate (ORR), defined as proportion of subjects with a complete response (CR) or partial response (PR) according to RECIST v1.1, for each cohort (cohort 1 – bemarituzumab plus irinotecan, cohort 2 – bemarituzumab plus paclitaxel and ramucirumab, cohort 3 – bemarituzumab plus trifluridine/tipiracil)

Source: https://euclinicaltrials.eu/ctis-public/view/2024-512484-31-00